EU clinical trial 2025-522598-12-00: A randomized, phase 2/3 study comparing BMS-986504 in combination with Nab-paclitaxel and Gemcitabine versus placebo in combination with Nab-paclitaxel and Gemcitabine in participants with untreated metastatic pancreatic ductal adenocarcinoma harboring homozygous MTAP deletion
Protocol code: CA240-0030
Sponsor: Bristol-Myers Squibb Services Unlimited Company (Pharmaceutical company). Phase: Phase II and Phase III (Integrated). Countries: Czechia (ongoing, recruitment ended), Austria (ongoing, recruitment ended), Belgium (ongoing, recruitment ended), Ireland (authorised, recruiting), Spain (ongoing, recruitment ended), Germany (ongoing, recruitment ended), Romania (ongoing, recruitment ended), Netherlands (authorised, recruiting), Slovakia (authorised, recruitment pending), Greece (authorised, recruiting), Poland (ongoing, recruitment ended), Italy (ongoing, recruitment ended), Denmark (ongoing, recruitment ended), France (ongoing, recruitment ended), Sweden (ongoing, recruitment ended).
Therapeutic area(s): Diseases [C] - Neoplasms [C04]
Gender: Female, Male. Age: 18-64 years, 65+ years. Enrolment: 162.
Start date (EU): 2025-12-17. Decision date: 2025-11-28. Results received: No. Last updated: 2026-05-04.
Decision dates by country: CZ: 2025-11-28, FR: 2025-12-02, IE: 2025-12-03, ES: 2025-12-03, SK: 2025-12-01, AT: 2025-12-04, DK: 2025-12-05, RO: 2025-12-08, GR: 2025-12-02, SE: 2025-12-05, IT: 2026-01-12, PL: 2025-12-01, NL: 2025-12-03, BE: 2025-12-01, DE: 2025-12-04

Condition(s): Untreated Metastatic Pancreatic Ductal Adenocarcinoma
Product: GEMCITABINE, Mrtx1719 matching placebo, PACLITAXEL ALBUMIN-BOUND, MRTX1719

Primary endpoint: Time to disease worsening on scans and time to death (Phase 3)
Endpoint(s): Rate of tumor shrinkage, duration of tumor shrinkage, time to tumor shrinkage, and rate of participants with control of tumor growth and/or shrinkage

Source: https://euclinicaltrials.eu/ctis-public/view/2025-522598-12-00